EU clinical trial 2024-518326-32-00: PHASE 1/2 STUDY OF PARG INHIBITOR ETX-19477 IN PATIENTS WITH ADVANCED SOLID MALIGNANCIES
Sponsor: 858 Therapeutics Inc. (Pharmaceutical company). Phase: Phase I and Phase II (Integrated)- First administration to humans. Countries: Spain (authorised, recruiting), France (ongoing, recruiting), Italy (authorised, recruitment pending).
Therapeutic area(s): Diseases [C] - Neoplasms [C04]
Gender: Female, Male. Age: 18-64 years, 65+ years. Enrolment: 28.
Start date (EU): 2026-07-10. Decision date: 2025-03-31. Results received: No. Last updated: 2026-07-27.
Decision dates by country: FR: 2025-04-02, ES: 2025-03-31, IT: 2025-04-01

Condition(s): Patients with advanced solid malignancies that have progressed following standard therapy
Product: EXT-19477, ETX-19477, ETX-19477

Primary endpoint: Phase 1: - Frequency of dose-limiting toxicities (DLTs) - Frequency and severity of AEs, including abnormal ECG parameters, and serious adverse events (SAEs), Phase 2a: Objective response rate
Endpoint(s): Phase 1: -Plasma concentrations of ETX-19477 as a function of time post-dosing -PK parameters for single (first) dose and multiple doses, Phase 1: - Objective response rate (ORR) - Duration of response (DOR) - Disease control rate (DCR) - Progression-free survival (PFS), Phase 2a: To compare two (or more) dose levels of ETX-19477 with respect to efficacy (ORR, DOR, DCR, PFS), safety, and tolerability in order to select the optimal dose and schedule for Phase 3 development in accordance with FDA's Project Optimus initiative., Phase 2a: - Frequency and severity of AEs and SAEs, dose modifications., Phase 2a: - Duration of response (DOR) - Disease control rate (DCR) - Progression-free survival (PFS)

Source: https://euclinicaltrials.eu/ctis-public/view/2024-518326-32-00